EU clinical trial 2024-510633-17-00: OPTIMAL DIURETIC THERAPIES FOR ACUTE HEART FAILURE WITH VOLUME OVERLOAD
Sponsor: Region Hovedstaden (Hospital/Clinic/Other health care facility). Phase: Therapeutic confirmatory (Phase III). Countries: Denmark (ongoing, recruiting).
Therapeutic area(s): Diseases [C] - Cardiovascular Diseases [C14]
Gender: Female, Male. Age: 18-64 years, 65+ years. Enrolment: 939.
Status: Ongoing, recruiting. Start date (EU): 2024-09-05. Decision date: 2024-04-15. Results received: No. Last updated: 2026-04-07.

Condition(s): acute heart failure
Product: METOLAZONE, inert tablets identical with metolazone, Saline identical with acetazolamide, Acetazolamide 500mg Powder for solution for Injection

Primary endpoint: Days alive and outside hospital until day 30
Endpoint(s): 1. Clinical benefit at 30 days, consisting of a composite of 1. all-cause death, 2. Readmission after discharge from initial hospitalization, 3. new receipt of renal-replacement therapy, or persistent renal dysfunction (defined as a final inpatient creatinine value ≥200% of the baseline value), assessed using a Hierarchical win-ratio’ approach. 2. Days alive and outside hospital until day 90 3. Days of admittance in the primary admission

Source: https://euclinicaltrials.eu/ctis-public/view/2024-510633-17-00